EU clinical trial 2024-514850-59-00: Laparoscopic Antibiotic Lavage to Prevent intra-abdominal Abscess formation in Complicated Appendicitis (ALPACA), a multicenter single-blinded RCT
Sponsor: Stichting Amsterdam UMC, Spaarne Gasthuis Stichting (Hospital/Clinic/Other health care facility). Phase: Therapeutic confirmatory (Phase III). Countries: Netherlands (ongoing, recruiting).
Therapeutic area(s): Diseases [C] - Digestive System Diseases [C06]
Gender: Female, Male. Age: 0-17 years, 18-64 years, 65+ years. Enrolment: 752.
Status: Ongoing, recruiting. Start date (EU): 2025-02-24. Decision date: 2025-01-27. Results received: No. Last updated: 2026-03-10.

Condition(s): Appendicitis
Product: GENTAMICIN, CLINDAMYCIN

Primary endpoint: Incidence of postoperative intra-abdominal abscess within 30 days follow-up
Endpoint(s): Wound infections (90 days), Treatment of IAA (90 days), Microbial cultures of intra-operative aspirate and of postoperative IAA (90 days), Operating time (time from incision to wound closure - 90 days), Readmission rate (90 days), Reoperation rate (90 days), Hospital length-of-stay (including readmission - 90 days), Surgical complications according to the Clavien-Dindo classification (90 days), Mortality (90 days), Adverse events of antibiotic peritoneal lavage (90 days), Quality of life (90 days), Postoperative consultations (90 days), Cost-effectivity (90 days)

Source: https://euclinicaltrials.eu/ctis-public/view/2024-514850-59-00